EU clinical trial 2023-507381-13-00: Single-Arm, Phase 2 Study of Valemetostat Tosylate Monotherapy in Subjects with Relapsed/Refractory Peripheral T-Cell Lymphoma
Protocol code: DS3201-A-U202
Sponsor: Daiichi Sankyo Inc. (Pharmaceutical company). Phase: Therapeutic exploratory (Phase II). Countries: Italy (ongoing, recruitment ended), France (ongoing, recruitment ended), Spain (ongoing, recruitment ended).
Therapeutic area(s): Diseases [C] - Neoplasms [C04]
Gender: Female, Male. Age: 18-64 years, 65+ years. Enrolment: 61.
Status: Ongoing, recruitment ended. Start date (EU): 2021-11-03. Decision date: 2024-02-06. Results received: No. Last updated: 2026-08-08.
Decision dates by country: FR: 2024-02-08, ES: 2024-02-06, IT: 2024-02-08

Condition(s): Relapsed/Refractory Peripheral T-Cell Lymphoma
Product: Valemetostat Tosylate, Valemetostat Tosylate

Primary endpoint: Cohort 1 ORR is defined as the proportion of subjects with a BOR of CR or PR, assessed by BICR, among subjects with centrally confirmed PTCL-eligible histology., Cohort 2 All safety assessments, including AE reporting (TEAEs; TEAESIs; TESAEs; TEAEs by severity [CTCAE grading, including Grade 3 and Grade 4]; fatal events; and TEAEs leading to treatment discontinuation, interruption, or reduction), laboratory assessments, vital signs, and ECG (including QTcF by central ECG reading)
Endpoint(s): All Cohorts Total and unbound DS-3201a (free form of valemetostat tosylate) and total CALZ-1809a (major metabolite) concentration in plasma, Cohort 1 only DoR is defined as the time from the date of the first documentation of objective response (CR or PR) to the date of the first documentation of disease progression (progressive orrelapsed disease) based on BICR assessments or to death due to any cause, whichever occurs first., Cohort 1 only CR rate is the percentage of subjects achieving CR as the BOR based onBICR., Cohort 1 only DoCR is defined as the time from the date of the first documentation of CR to the date of the first documentation of disease progression (progressive or relapsed disease) based on BICR assessments or to death due to any cause, whichever occurs first., Cohort 1 only PR rate is the percentage of subjects achieving PR as the BOR based onBICR assessment., Cohort 1 only All safety assessments, including AE reporting (TEAEs; TEAESIs; TESAEs; TEAEs by severity CTCAE grading, including Grade 3 and Grade 4; fatal events; and TEAEs leading to treatment discontinuation, interruption, or reduction), laboratory assessments, vital signs, and ECG (including QTcF by central ECG reading), Cohort 1 only PFS is defined as the time interval from the date of the first dose of study drug to the date of disease progression (progressive or relapsed disease) or death due to any cause. Disease progression will be evaluated by investigator assessments, Cohort 1 only OS is defined as the time interval from the date of the first dose of study drug to the date of death due to any cause

Source: https://euclinicaltrials.eu/ctis-public/view/2023-507381-13-00